EU clinical trial 2024-514307-34-01: A randomized, double-blind parallel group study to investigate propofol injection pain compared with placebo in healthy adult male and female participants. (PropPain)
Sponsor: Oslo University Hospital HF (Hospital/Clinic/Other health care facility). Phase: Therapeutic exploratory (Phase II). Countries: Norway (ended).
Therapeutic area(s): Analytical, Diagnostic and Therapeutic Techniques and Equipment [E] - Anesthesia and Analgesia [E03]; Diseases [C] - Nervous System Diseases [C10]; Analytical, Diagnostic and Therapeutic Techniques and Equipment [E] - Therapeutics [E02]
Gender: Female, Male. Age: 18-64 years. Enrolment: 96.
Status: Ended. Start date (EU): 2025-09-01. End date (EU): 2026-06-06. Decision date: 2025-04-01. Results received: No. Last updated: 2025-11-07.

Condition(s): Pain
Product: Propolipid 10 mg/ml injeksjons-/infusjonsvæske, emulsjon, SALINE

Primary endpoint: • Proportion of participants with VAS≥30 mm (0-100mm)
Endpoint(s): • • Max electronic Visual Analog Scale (VAS) pain (0-100 mm), • Max Numeric Rating Scale (NRS) pain (0-10), • Time (seconds) to max electronic Visual Analog Scale (VAS) pain, • Area under the curve (AUC) 0-1 min, 1-2 min, 2-3 min, • Area under the curve VAS≥30 (AUCVAS≥30) 0-1 min, 1-2 min, 2-3 min, • Curve shape of electronic Visual Analog Scale (VAS) pain (0-100 mm) by description of the curve (number of peaks), • Max Numeric Rating Scale (NRS) pain (0-10), • Richmond Agitation-Sedation Scale (RASS)

Source: https://euclinicaltrials.eu/ctis-public/view/2024-514307-34-01